EU clinical trial 2024-518951-52-00: Corticotrophin Releasing Factor 2 Agonist For the Treatment of Worsening Heart Failure (WHF) – The CRAFT-WHF Study
Protocol code: COR1167-201
Sponsor: Corteria Pharmaceuticals (Pharmaceutical company). Phase: Therapeutic exploratory (Phase II). Countries: Czechia (temporarily halted), Spain (temporarily halted), Romania (temporarily halted), Hungary (temporarily halted), Poland (temporarily halted).
Therapeutic area(s): Diseases [C] - Cardiovascular Diseases [C14]
Gender: Female, Male. Age: 18-64 years, 65+ years. Enrolment: 170.
Status: Temporarily halted. Start date (EU): 2025-11-12. Decision date: 2025-07-15. Results received: No. Last updated: 2026-03-31.
Decision dates by country: PL: 2025-07-18, HU: 2025-07-15, CZ: 2025-07-15, ES: 2025-07-18, RO: 2025-07-18

Condition(s): Worsening Heart Failure
Product: Placebo solution for injection matching COR-1167, COR-1167

Primary endpoint: The primary endpoints are the individual assessments of the dose-effect relationship of COR-1167 on: • Natriuresis • Body weight • NT-proBNP • KCCQ-TSS • LAVi
Endpoint(s): Safety and tolerability of 3 s.c. o.d. doses of COR-1167, as assessed by the following parameters: o Clinical safety laboratory parameters (hematology, chemistry, coagulation, urinalysis, eGFR) o Vital signs (blood pressure, heart rate, respiratory rate, and body temperature) o Physical examinations o 12-lead electrocardiogram (ECG) o Adverse events (AEs), Anti-drug antibody (ADA) semi-quantitative determination after 28-day treatment with COR-1167

Source: https://euclinicaltrials.eu/ctis-public/view/2024-518951-52-00